EU clinical trial 2023-509931-15-00: Efficacy and Safety of Cryotherapy followed by Tirbanibulin ointment for actinic keratosis on the scalp and forehead
Protocol code: DRI_2023_0127
Sponsor: Centre Hospitalier Universitaire De Lille (Hospital/Clinic/Other health care facility). Phase: Phase III and phase IV (Integrated). Countries: France (authorised, recruitment pending).
Therapeutic area(s): Not possible to specify
Gender: Female, Male. Age: 18-64 years, 65+ years. Enrolment: 59.
Status: Authorised, recruitment pending. Decision date: 2024-06-28. Results received: No. Last updated: 2026-07-27.

Condition(s): Patients (male or female) ≥18 years old with scalp and forehead actinic keratoses
Product: Le placebo possède les mêmes caractéristiques que le traitement Klisyri 10mg/g sans la substance active. Il est produit et fourni par le même producteur que le Klisyri., Klisyri 10 mg/g ointment

Primary endpoint: Complete response rate of actinic keratosis at 8 months. A complete response corresponds to the absence of clinically detectable actinic keratosis in the treated area.
Endpoint(s): Complete response rate for actinic keratosis at 12 months., Partial response rate (= 75% reduction of lesions) at 8 months., Partial response rate (= 75% reduction of lesions) at 12 months., Number of cryotherapy sessions carried out over the follow-up period., Collection of the following local skin reactions: erythema, desquamation, crusts, oedema, vesicles/pustules, erosions/ulcerations and gradation on a scale from 0 to 3: 0=absent, 1=light (barely perceptible), 2=moderate (obvious presence), 3=severe (marked, intense). Assessment of pain using a visual analogue scale from 0 to 10., The photographs taken during the visits will be analysed using computer-aided image processing.

Source: https://euclinicaltrials.eu/ctis-public/view/2023-509931-15-00